EU clinical trial 2024-510866-18-00: Comparative study of the mechanism of action of Dry Needling and Botulinum Toxin type A as a treatment for lower limb post-stroke spasticity: a proof of concept controlled trial
Protocol code: 49317
Sponsor: University Of Antwerp (Educational Institution). Phase: Therapeutic exploratory (Phase II). Countries: Spain (authorised, recruiting), Belgium (ongoing, recruiting).
Therapeutic area(s): Phenomena and Processes [G] - Musculoskeletal and Neural Physiological Phenomena [G11]; Diseases [C] - Musculoskeletal Diseases [C05]; Diseases [C] - Nervous System Diseases [C10]; Analytical, Diagnostic and Therapeutic Techniques and Equipment [E] - Therapeutics [E02]
Gender: Female, Male. Age: 18-64 years, 65+ years. Enrolment: 60.
Start date (EU): 2025-02-21. Decision date: 2024-07-15. Results received: No. Last updated: 2026-03-02.
Decision dates by country: BE: 2024-07-15, ES: 2024-07-22

Condition(s): Spasticity after Stroke
Product: BOTOX 100 Allergan Units Powder for solution for injection, BOTOX 50 Allergan Units Powder for solution for injection

Primary endpoint: Spasticity: it will be measured with the Tonic Stretch Reflex Threshold and its velocity sensitivity. It will be assessed weekly during 15 weeks (in week 3, two assessments will be conducted- one before the treatment and one after) and on the 19th week
Endpoint(s): Resistance to passive stretching: measured with the Modified Ashworth Scale (MAS) It will be assessed weekly during 15 weeks and on the 19th week (in week 3, two assessments will be conducted- one before the treatment and one after)., Gait: measured with instrumented gait analysis and the 10 Meter Walk Test (10MWT). It will be assessed on week 1, 2, 9, 15 and 19, Functional mobility: measured with the Time Up and Go (TUG). Assessed on week 1, 2, 9, 15 and 19, Muscle ultrasound (morphometric and densitometric variables): measured with ultrasound imaging. Assessed every week from 1 to 15 and on the 19 week (in week 3, two assessments will be conducted - one before the treatment and one after), Quality of life: measured with the EuroQoL-5D. Assessed on week 1, 15 and 19, Cost-effectiveness: measured with a cost-effectiveness analysis. It will be done after every intervention session (from 3 to 15 week and on 19), sample size, recruitment, and consent rates will be determined, as well as the safety and feasibility of both treatments

Source: https://euclinicaltrials.eu/ctis-public/view/2024-510866-18-00